EU clinical trial 2022-502420-51-00: An open label, randomized, four-period, four-sequence single dose, crossover trial in healthy volunteers to determine the relative bioavailability of Dimenhydrinate 50 mg (Test) administered with and without water vs. Vomex A 50 mg Lösung zum Einnehmen im Beutel (Reference 1) and Biodramina 50 mg Comprimidos (Reference 2)
Protocol code: CHE21003
Sponsor: CCDRD Cooperative Clinical Drug Research and Development AG, Hermes Pharma GmbH (Pharmaceutical company). Phase: Human Pharmacology (Phase I)- Bioequivalence Study. Countries: Bulgaria (ended).
Therapeutic area(s): Diseases [C] - Nutritional and Metabolic Diseases [C18]
Gender: Female, Male. Age: 18-64 years. Enrolment: 14.
Status: Ended. Start date (EU): 2023-10-23. End date (EU): 2023-12-13. Decision date: 2023-10-02. Results received: Yes. Last updated: 2023-10-02.

Condition(s): No therapeutic indication in the current trial with healthy volunteers. The intended indication is for the prophylaxis and symptomatic therapy of nausea and vomiting of various etiologies, especially kinetosis.
Product: Vomex A 50 mg Lösung zum Einnehmen im Beutel, Biodramina 50 mg Comprimidos

Primary endpoint: AUC(0-t) and Cmax of diphenhydramine
Endpoint(s): tmax of diphenhydramine

Source: https://euclinicaltrials.eu/ctis-public/view/2022-502420-51-00